EU clinical trial 2023-505478-14-00: A Phase 3, Randomized, Double-Blind, Study Comparing Risankizumab to Placebo in Subjects with Active Psoriatic Arthritis (PsA) Who Have a History of Inadequate Response to or intolerance to at Least One Disease Modifying Anti-Rheumatic Drug (DMARD) Therapy (KEEPsAKE 1)
Protocol code: M16-011
Sponsor: AbbVie Deutschland GmbH & Co. KG (Pharmaceutical company). Phase: Therapeutic confirmatory (Phase III). Countries: Italy (ended), Czechia (ongoing, recruitment ended), Belgium (ongoing, recruitment ended), Croatia (ended), Portugal (ongoing, recruitment ended), Germany (ongoing, recruitment ended), Bulgaria (ongoing, recruitment ended), Lithuania (ongoing, recruitment ended), Spain (ongoing, recruitment ended), Finland (ended), Estonia (ongoing, recruitment ended), Greece (ended), Romania (ended), Slovakia (ongoing, recruitment ended), Latvia (ended), Denmark (ongoing, recruitment ended), Poland (ongoing, recruitment ended).
Therapeutic area(s): Diseases [C] - Skin and Connective Tissue Diseases [C17]; Diseases [C] - Immune System Diseases [C20]
Gender: Female, Male. Age: 18-64 years, 65+ years. Enrolment: 337.
Start date (EU): 2019-05-09. Decision date: 2024-02-29. Results received: No. Last updated: 2026-07-31.
Decision dates by country: SK: 2024-02-29, HR: 2024-03-01, FI: 2024-02-29, ES: 2024-03-01, DE: 2024-02-29, DK: 2024-02-29, IT: 2024-03-05, PT: 2024-03-01, LT: 2024-03-28, GR: 2024-04-08, CZ: 2024-03-01, EE: 2024-03-05, BE: 2024-03-08, BG: 2024-03-01, RO: 2024-03-04, LV: 2024-02-29, PL: 2024-03-08

Condition(s): Psoriatic Arthritis
Product: ABBV-066, Placebo for Risankizumab Solution for injection in prefilled syringe, Risankizumab

Primary endpoint: Proportion of subjects achieving ACR 20 response (ACR20) at Week 24.
Endpoint(s): Change from Baseline in Health Assessment Questionnaire – Disability Index (HAQ-DI) at Week 24., Proportion of subjects achieving PASI 90 response at Week 24 (in the subset of subjects with a body surface area [BSA] ≥ 3% at Baseline., Proportion of subjects achieving ACR20 at Week 16., Proportion of subjects achieving MDA at Week 24., Change from Baseline in modified Nail Psoriasis Severity Index (mNAPSI) at Week 24 in the subset of subjects with nail PsO at Baseline., Change from Baseline in Physician Global Assessment of Fingernail Psoriasis (PGA-F) at Week 24 in the subset of subjects with nail PsO at Baseline., Proportion of subjects with resolution of enthesitis (Leeds Enthesitis Index [LEI] = 0) at Week 24 in subjects with enthesitis at Baseline., Proportion of subjects with resolution of dactylitis (Leeds Dactylitis Index [LDI] = 0) at Week 24 in subjects with dactylitis at Baseline., Change from Baseline in modified Total Sharp Score (PsA mTSS) at Week 24., Change from Baseline in 36-Item Short Form Health Survey (SF-36) Physical Component Summary (PCS) at Week 24., Change from Baseline in Functional Assessment of Chronic Illness Therapy-Fatigue (FACITFatigue) Questionnaire at Week 24., Proportion of subjects achieving ACR50 response at Week 24., Proportion of subjects achieving ACR70 response at Week 24.

Source: https://euclinicaltrials.eu/ctis-public/view/2023-505478-14-00